EU clinical trial 2024-514461-19-00: Phase 1/2 dose escalation and expansion study evaluating MCLA-129, a human anti-EGFR and anti-c-MET bispecific antibody, in patients with advanced NSCLC and other solid tumors
Protocol code: MCLA-129-CL01
Sponsor: Merus B.V. (Pharmaceutical company). Phase: Phase I and Phase II (Integrated)- Other. Countries: Belgium (ongoing, recruitment ended), Spain (ongoing, recruitment ended), Netherlands (ongoing, recruitment ended), Italy (ongoing, recruitment ended), France (ongoing, recruitment ended), Germany (ended).
Therapeutic area(s): Diseases [C] - Neoplasms [C04]
Gender: Female, Male. Age: 18-64 years, 65+ years. Enrolment: 238.
Start date (EU): 2021-09-09. Decision date: 2024-10-14. Results received: No. Last updated: 2026-02-12.
Decision dates by country: BE: 2024-10-18, DE: 2024-10-21, IT: 2024-12-03, ES: 2024-10-21, NL: 2024-10-14, FR: 2024-10-17

Condition(s): Solid Tumors
Product: DOCETAXEL, OSIMERTINIB, PACLITAXEL, OSIMERTINIB, CARBOPLATIN

Primary endpoint: Objective Response Rate (ORR), Frequency and severity of adverse events, serious adverse events, treatment discontinuations and modifications, Pharmacokinetic parameters (CEOI, Cmax, C0h, AUC, CL, Vss, tmax and t1/2,) and population pharmacokinetics, Progression-Free Survival (PFS) and Duration of Response (DOR), Overall Survival (OS)

Source: https://euclinicaltrials.eu/ctis-public/view/2024-514461-19-00